EU clinical trial 2023-505775-70-00: A multi-center, open-label, phase 2 study of Elranatamab in patients with high-risk smoldering multiple myeloma
Protocol code: EMN34
Sponsor: European Myeloma Network B.V., Emn Trial Office S.r.l. Impresa Sociale (Patient organisation/association, Laboratory/Research/Testing facility). Phase: Therapeutic exploratory (Phase II). Countries: France (ongoing, recruitment ended), Greece (ended), Netherlands (ongoing, recruitment ended), Norway (ongoing, recruitment ended), Finland (ended), Italy (ongoing, recruitment ended).
Therapeutic area(s): Diseases [C] - Neoplasms [C04]
Gender: Female, Male. Age: 18-64 years, 65+ years. Enrolment: 105.
Start date (EU): 2024-04-08. Decision date: 2024-02-13. Results received: No. Last updated: 2026-08-03.
Decision dates by country: GR: 2024-02-16, FI: 2024-02-13, IT: 2024-06-18, NO: 2024-06-14, FR: 2024-02-13, NL: 2024-02-15

Condition(s): High risk smoldering multiple myeloma
Product: DIPHENHYDRAMINE HYDROCHLORIDE, RoActemra 20 mg/mL concentrate for solution for infusion, PARACETAMOL, DEXAMETHASONE, ELRANATAMAB

Primary endpoint: Complete remission rate at the end of cycle 6, assessed by International Myeloma Working Group [IMWG] criteria., Rate of grade >3-4 non hematologic adverse events, assessed according to CTCAE 5.0.

Source: https://euclinicaltrials.eu/ctis-public/view/2023-505775-70-00